EU clinical trial 2025-523412-36-00: A clinical study of MK-1045 in people with lupus or rheumatoid arthritis (MK-1045-004)
Protocol code: MK-1045-004
Sponsor: Merck Sharp & Dohme LLC (Pharmaceutical company). Phase: Human Pharmacology (Phase I)- Other. Countries: Italy (ongoing, recruiting), Belgium (ongoing, recruiting), Romania (ongoing, recruiting).
Therapeutic area(s): Diseases [C] - Immune System Diseases [C20]
Gender: Female, Male. Age: 18-64 years, 65+ years. Enrolment: 11.
Status: Ongoing, recruiting. Start date (EU): 2026-02-17. Decision date: 2026-02-02. Results received: No. Last updated: 2026-07-29.
Decision dates by country: RO: 2026-02-09, IT: 2026-02-02, BE: 2026-02-04

Condition(s): Systemic lupus erythematosus, Rheumatoid arthritis

Source: https://euclinicaltrials.eu/ctis-public/view/2025-523412-36-00